EU clinical trial 2025-521924-31-00: A Study to Learn If The Study Medicine Called Fluconazole Changes How the Body Processes The Other Study Medicine PF-07248144
Protocol code: C4551010
Sponsor: Pfizer Inc. (Pharmaceutical company). Phase: Human Pharmacology (Phase I)- Other. Countries: Belgium (ended).
Therapeutic area(s): Diseases [C] - Neoplasms [C04]
Gender: Female, Male. Age: 18-64 years, 65+ years. Enrolment: 12.
Status: Ended. Start date (EU): 2025-08-20. End date (EU): 2025-11-04. End date: 2025-11-05. Decision date: 2025-07-15. Results received: No. Last updated: 2025-08-19.

Condition(s): locally advanced or metastatic HR+/HER2- breast cancer

Source: https://euclinicaltrials.eu/ctis-public/view/2025-521924-31-00